EU clinical trial 2024-513019-29-00: A Randomized, Double-Blind, Placebo-Controlled, Parallel-Group, Multi-Center Study to Compare the Anti-Depressive Efficacy and Safety of Samyr® Tablet versus Placebo Tablet on top of Adjunctive Antidepressant Treatment in Patients with Major Depression Disorder with Mild to Moderate Symptoms
Protocol code: MYL-1603N-3001
Sponsor: Mylan Inc. (Pharmaceutical company). Phase: Therapeutic confirmatory (Phase III). Countries: Italy (ongoing, recruiting).
Therapeutic area(s): Psychiatry and Psychology [F] - Mental Disorders [F03]
Gender: Female, Male. Age: 18-64 years, 65+ years. Enrolment: 600.
Status: Ongoing, recruiting. Start date (EU): 2024-03-22. Decision date: 2024-10-09. Results received: No. Last updated: 2026-07-29.

Condition(s): Major Depression Disorder
Product: SAMYR 400 mg compresse gastroresistenti, Samyr placebo (same excipient as SAMYR)

Primary endpoint: The primary endpoint is the change from baseline in the HDRS-17 score after 6 weeks of treatment (visit 9).
Endpoint(s): Change from baseline of the PGI and CGI scales after 6 weeks of treatment (visit 9).

Source: https://euclinicaltrials.eu/ctis-public/view/2024-513019-29-00